EU clinical trial 2024-510863-50-00: CABONEN – a phase II trial of Cabozantinib in patients with advanced, low proliferative NEN G3
Protocol code: 02679
Sponsor: Universitaetsmedizin Goettingen (Hospital/Clinic/Other health care facility). Phase: Therapeutic exploratory (Phase II). Countries: Austria (ended), Germany (ended).
Therapeutic area(s): Diseases [C] - Neoplasms [C04]
Gender: Female, Male. Age: 18-64 years, 65+ years. Enrolment: 45.
Status: Ended. Start date (EU): 2024-08-30. End date (EU): 2026-05-18. Decision date: 2024-08-30. Results received: No. Last updated: 2026-04-27.
Decision dates by country: DE: 2024-08-30, AT: 2024-09-02

Condition(s): Neuroendocrine Neoplasia Neuroendocrine Tumor
Product: CABOMETYX 40 mg film-coated tablets, CABOMETYX 20 mg film-coated tablets, CABOMETYX 60 mg film-coated tablets

Primary endpoint: Disease control rate (DCR) 6 months after treatment start (Complete Response (CR) + Partial Response (PR) + Stable Disease (SD))
Endpoint(s): Disease control rate 3 and 12 months after treatment start, Objective response rate (ORR) 3 months after treatment start and best objective response rate, Progression free survival (PFS) and overall survival (OS), Time on drug (TOD), EORTC QLQ-C30 Quality of Life Questionnaire monthly for 12 months after treatment start and after 15 months, Serious adverse events and adverse events, Data Safety Monitoring Board (DSMB)

Source: https://euclinicaltrials.eu/ctis-public/view/2024-510863-50-00